EU clinical trial 2024-516504-42-00: A randomised controlled trial in preterm infants comparing prophylactic with selective “Less Invasive Surfactant Administration” (pro.LISA)
Protocol code: pro.LISA_01_21
Sponsor: Universitaetsklinikum Schleswig-Holstein AöR (Hospital/Clinic/Other health care facility). Phase: Therapeutic confirmatory (Phase III). Countries: Germany (ongoing, recruiting).
Therapeutic area(s): Diseases [C] - Respiratory Tract Diseases [C08]
Gender: Female, Male. Age: 0-17 years. Enrolment: 578.
Status: Ongoing, recruiting. Start date (EU): 2022-03-05. Decision date: 2024-07-31. Results received: No. Last updated: 2026-03-11.

Condition(s): Respiratory distress syndrome in preterm infants
Product: ALVEOFACT® 45 mg/ml 54 mg, Pulver und Lösungsmittel zur Herstellung einer Suspension, Curosurf® 120 mg Suspension zur endotracheopulmonalen Instillation

Primary endpoint: Forced expiratory volume within the first second (... Forced expiratory volume within the first secoForced expiratory volume within the first second (FEV1) at 5 years of age (Global Lung Function Initiative z-score).
Endpoint(s): At the age of 5 years: (1) FVC z-score, (2) FEV1/FVC z-score, (3) walking distance in the 3-minute walk test, (4) obstructive bronchitis treated with medication in the last 12 months, (5) cerebral palsy, defined as Gross Motor Function Classification System values > 1, (6) values in the Movement Assessment Battery for Children score, (7) intelligence quotient, determined with the WPPSI IV

Source: https://euclinicaltrials.eu/ctis-public/view/2024-516504-42-00